EU clinical trial 2025-522513-30-00: A trial to learn how well different doses of andexanet alfa work and how they affect blood clotting throughout the body in healthy adults who have taken an FXa inhibitor
Protocol code: D9609C00001
Sponsor: AstraZeneca AB (Pharmaceutical company). Phase: Human Pharmacology (Phase I)- Other. Countries: Germany (ended).
Therapeutic area(s): Not possible to specify
Gender: Female, Male. Age: 18-64 years. Enrolment: 108.
Status: Ended. Start date (EU): 2026-01-12. End date (EU): 2026-06-22. End date: 2026-06-23. Decision date: 2026-01-09. Results received: No. Last updated: 2026-06-10.

Condition(s): Healthy Volunteers

Source: https://euclinicaltrials.eu/ctis-public/view/2025-522513-30-00